EU clinical trial 2023-503836-41-00: A Randomized, Double-Blind, Placebo-controlled Multicenter Study to Assess the Efficacy and Safety of Lumateperone as Adjunctive Therapy in the Treatment of Patients with Major Depressive Disorder (ITI-007-505)
Protocol code: ITI-007-505
Sponsor: Intra-Cellular Therapies Inc. (Pharmaceutical company). Phase: Therapeutic confirmatory (Phase III). Countries: Spain (ongoing, recruiting), Lithuania (ongoing, recruiting), France (ongoing, recruiting), Bulgaria (ongoing, recruiting).
Therapeutic area(s): Psychiatry and Psychology [F] - Mental Disorders [F03]
Gender: Female, Male. Age: 18-64 years, 65+ years. Enrolment: 155.
Status: Ongoing, recruiting. Start date (EU): 2025-03-10. Decision date: 2024-03-05. Results received: No. Last updated: 2026-01-26.
Decision dates by country: LT: 2024-03-05, ES: 2024-05-15, FR: 2024-03-08, BG: 2024-03-11

Condition(s): Major Depressive Disorder
Product: Placebo capsules (not containing the active substance, otherwise identical to lumateperone capsules)

Primary endpoint: Change from Baseline (Visit 2) to Day 43 (Visit 8) in MADRS total score.
Endpoint(s): Key secondary efficacy endpoint is the change from baseline to Day 43 in the CGI-S score., The proportion of patients who are treatment responders where response is defined as a ≥ 50% decrease from baseline in MADRS total score at Day 43;, The proportion of remitters, where remission is defined as a MADRS total score ≤ 10 at Day 43;, By-visit mean change from baseline in the MADRS total score;, By-visit mean change from baseline in the HAM-A total score;, By-visit mean change from baseline in the CSFQ-14 total score;, By-visit mean change from baseline in CGI-S score;, Change from baseline in MADRS individual item scores at each assessment time point, including Day 43;, Safety parameters (AEs, clinical laboratory, vital signs, ECG, and EPS (AIMS, BARS, and SAS) and C-SSRS scales)

Source: https://euclinicaltrials.eu/ctis-public/view/2023-503836-41-00